EU clinical trial 2023-505375-75-00: SGLT2 inhibitor TrEatment iN patients awaiting cOronary arTery bYpass surgery to reduce Post-opErative atrial fibrillation and kidney injury (STENOTYPE trial).
Protocol code: STENOTYPE-2023
Sponsor: Region Oerebro Laen (Hospital/Clinic/Other health care facility). Phase: Therapeutic confirmatory (Phase III). Countries: Denmark (ongoing, recruiting), Sweden (ongoing, recruiting), Czechia (ongoing, recruiting).
Therapeutic area(s): Diseases [C] - Cardiovascular Diseases [C14]
Gender: Female, Male. Age: 18-64 years, 65+ years. Enrolment: 800.
Status: Ongoing, recruiting. Start date (EU): 2024-04-04. Decision date: 2024-01-18. Results received: No. Last updated: 2026-08-03.
Decision dates by country: CZ: 2024-07-15, SE: 2024-04-15, DK: 2024-04-15

Condition(s): Onset of Atrial Fibrillation and Acute Kidney Injury after coronary artery bypass surgery (CABG)
Product: Forxiga 10 mg film-coated tablets, Placebo tablet. View the simplified IMPD for description and composition.

Primary endpoint: AF lasting at least 30 seconds as detected on ECG or telemetry in-hospital after CABG surgery.
Endpoint(s): AKI, as defined by at least a 1.5-fold increase from baseline in serum creatinine within the prior seven days, an absolute increase in serum creatinine of 26.5 µmol/L or more within 48 hours, or a urine volume of less than 0.5 mL/kg/h for at least six hours, following Kidney Disease Improving Global Outcomes grade 1 or above. This condition is monitored in-hospital after CABG surgery., Safety and tolerability of dapagliflozin. Reported AEs, SAEs, and SUSAR from start of treatment until one-week post-discharge., All-cause mortality., Stroke., New onset heart failure., Ventricular arrhythmia., Electrical cardioversion for AF., Use of amiodarone for AF., Change in inflammatory and cardiac biomarkers from baseline to end of CABG surgery, 6±2 hours, 12±2 hours, and three days after CABG surgery., Change in HbA1c from baseline to three days after CABG surgery., Length of intensive care unit and hospital stay., 30-day all-cause mortality., 12-month all-cause mortality, 12-month myocardial infarction., 12-month stroke., 12-month hospital admission for AF or heart failure., 12-month dialysis treatment.

Source: https://euclinicaltrials.eu/ctis-public/view/2023-505375-75-00